EU clinical trial 2024-512508-21-00: L-carnitine as an adjunct treatment for septic shock patients with acute kidney injury: a multicentre, randomized, 2-parallel group, superiority trial
Sponsor: Centre Hospitalier Universitaire De Nimes (Hospital/Clinic/Other health care facility). Phase: Therapeutic confirmatory (Phase III). Countries: France (ongoing, recruitment ended).
Therapeutic area(s): Analytical, Diagnostic and Therapeutic Techniques and Equipment [E] - Diagnosis [E01]
Gender: Female, Male. Age: 18-64 years, 65+ years. Enrolment: 272.
Status: Ongoing, recruitment ended. Start date (EU): 2018-01-12. Decision date: 2024-04-26. Results received: No. Last updated: 2024-11-21.

Condition(s): shock septic
Product: SODIUM CHLORIDE, LEVOCARNITINE

Primary endpoint: Mortality
Endpoint(s): Mortality, Survival (verification of vital status and collection of death certificates to determine date of death), Days alive and not on renal replacement therapy, Days alive and free of renal failure, Days alive and free of organ failure, Days alive and not on mechanical ventilation, Days alive and not in ICU, Days alive and not in hospital, Days alive and free of catecholamines

Source: https://euclinicaltrials.eu/ctis-public/view/2024-512508-21-00